EU clinical trial 2023-509501-72-00: CAIRE : COMBINING EPIGENETIC AND IMMUNE THERAPY TO BEAT CANCER
Protocol code: IB 2019-04
Sponsor: Institut Bergonie (Hospital/Clinic/Other health care facility). Phase: Therapeutic exploratory (Phase II). Countries: France (ended).
Therapeutic area(s): Diseases [C] - Neoplasms [C04]
Gender: Female, Male. Age: 18-64 years, 65+ years. Enrolment: 173.
Status: Ended. Start date (EU): 2021-07-05. End date (EU): 2025-07-17. Decision date: 2024-10-31. Results received: No. Last updated: 2025-09-18.

Condition(s): Adult participants with metastatic or unresectable locally advanced solid tumors.
Product: TAZEMETOSTAT, IMFINZI 50 mg/mL concentrate for solution for infusion.

Primary endpoint: Participants with pancreatic cancer [Cohort A]: Disease control rate within 24 weeks of treatment onset is defined as the proportion of participants with confirmed complete response (CR), unconfirmed complete response (CRu), confirmed partial response (PR), unconfirmed partial response (PRu) or stable disease (SD), as per RECIST v1.1 criteria, observed within 24 weeks of treatment onset (while treated with the investigational product)., Participants with colorectal cancer not MSI-H or MMR-deficient [Cohort B]: Same primary endpoint as for cohort A., Participants with metastatic solid tumors with positive interferon gamma signature and/or tertiary lymphoid structure positive [Cohort C]: Objective response rate within 24 weeks of treatment onset is defined as the proportion of participants with confirmed complete response (CR), unconfirmed complete response (CRu), confirmed partial response (PR) or unconfirmed partial response (PRu), as per RECIST v1.1 criteria, observed within 24 weeks of treatment onset (while treated with the IP), Participants with soft-tissue sarcomas [Cohort D] : 6-month progression-free rate is defined as the proportion of participants with confirmed complete response (CR), unconfirmed complete response (CRu), confirmed partial response (PR) or unconfirmed partial response (PRu) or stable disease (SD) more than 24 weeks as per RECIST v1.1 criteria, observed within 6 months following treatment onset.
Endpoint(s): 6-month objective response rate is defined as the proportion of participants with confirmed complete response (CR), unconfirmed complete response (CRu), confirmed partial response (PR) or unconfirmed partial response (PRu) as per RECIST v1.1 criteria., Best overall response under treatment: best response (as per RECIST v1.1 criteria) recorded from the start of the study treatment until the end of treatment., Growth modulation index (GMI) is defined for each participant as the ratio of the PFS on the current treatment strategy to the PFS on the previous line of therapy (Von Hoff, 1998), in participants with documented progression at inclusion., Progression-free survival (PFS) is defined as the delay between the start date of treatment and the date of progression (as per RECIST v1.1) or death (from any cause), whichever occurs first. 6-month PFS and 1- year PFS rates will be reported., Overall survival (OS) is defined as the delay between the start date of treatment and the date of death (of any cause). 1-year OS rate will be reported., Safety profile of durvalumab in association with tazemetostat. Events will be graded using the Common Terminology Criteria for Adverse Events (CTCAE) from the NCI v5.0. Both AE and SAE will be coded according to the standardized medical terminology MedDRA., Pharmacodynamic (PD)/mechanism of action (MOA) biomarkers analysis as well as predictive biomarkers analysis (levels of immunologic biomarkers in blood/tissue at baseline and different study time points): Fresh tumor samples will be collected before tazemetostat dosing, after 3 weeks of treatment with tazemetostat (C2D1) and then at C3D1 (1 cycle of combo treatment)., 7a) Formalin-fixed, paraffin-embedded biopsy samples will be analyzed for (but not limited to) H3K27 (PD marker of tazemetostat), CD4, CD8, PDL1, CSF-1R, CD68/CD163, CD68/MHC class II, and other exploratory markers., 7b) Gene profiling: We will perform on all pre-treatment tumor samples whole-exome sequencing and RNA sequencing in order to identify : • Differences in point mutation and indel status in driver genes between responders and non-responders • Differences in mutational load between responders and non-responders • Differences in copy number alterations between responders and non-responders • Differences in expression profiling between responders and non responders.

Source: https://euclinicaltrials.eu/ctis-public/view/2023-509501-72-00